EU clinical trial 2023-506843-40-00: AKAPI: Amikacin Liposome Inhalation Suspension for treatment of Mycobacterium xenopi pulmonary infection: A prospective controlled open-label randomized study
Protocol code: PI2021_843_0148
Sponsor: Centre Hospitalier Universitaire Amiens Picardie (Hospital/Clinic/Other health care facility). Phase: Therapeutic confirmatory (Phase III). Countries: France (ongoing, recruiting).
Therapeutic area(s): Diseases [C] - Bacterial Infections and Mycoses [C01]
Gender: Female, Male. Age: 18-64 years, 65+ years. Enrolment: 190.
Status: Ongoing, recruiting. Start date (EU): 2025-10-29. Decision date: 2024-07-15. Results received: No. Last updated: 2025-10-24.

Condition(s): Mycobacterium xenopi pulmonary infection
Product: ARIKAYCE liposomal 590 mg nebuliser dispersion, RIFAMPICIN, DEXAMBUTOL 500 mg, comprimé pelliculé, CLARITHROMYCIN

Primary endpoint: 3 months sputum conversion rate
Endpoint(s): 6 months sputum conversion rate, recurrence, failure, relapse, cure, death and safety

Source: https://euclinicaltrials.eu/ctis-public/view/2023-506843-40-00